EU clinical trial 2022-501463-40-01: An Open-Label Early Access Phase 3b Study of Ivosidenib in Patients With a Pretreated Locally Advanced or Metastatic Cholangiocarcinoma
Protocol code: DIM-95031-002
Sponsor: Servier Affaires Medicales (Pharmaceutical company). Phase: Therapeutic confirmatory (Phase III). Countries: Germany (ended), Sweden (ongoing, recruitment ended), Netherlands (ongoing, recruitment ended), Austria (ended), Italy (ongoing, recruitment ended), Spain (ongoing, recruitment ended), France (ongoing, recruitment ended), Belgium (ended), Ireland (ongoing, recruitment ended), Romania (ongoing, recruiting).
Therapeutic area(s): Diseases [C] - Neoplasms [C04]
Gender: Female, Male. Age: 18-64 years, 65+ years. Enrolment: 202.
Start date (EU): 2023-05-03. Decision date: 2023-04-25. Results received: No. Last updated: 2025-12-05.
Decision dates by country: AT: 2023-05-19, IE: 2024-03-15, RO: 2024-03-25, FR: 2023-07-27, BE: 2023-08-01, SE: 2023-04-25, NL: 2023-04-25, DE: 2023-05-02, ES: 2023-07-20, IT: 2023-07-24

Condition(s): Locally Advanced or Metastatic Cholangiocarcinoma
Product: IVOSIDENIB

Primary endpoint: AEs, serious AEs (SAEs), AEs of special interest (AESIs), AEs leading to discontinuation or death, safety laboratory parameters, 12-lead ECG, vital signs, Eastern Cooperative Oncology Group (ECOG) performance status (PS)
Endpoint(s): • Response to treatment based on tumor assessments by the investigator according to local clinical practice o Progression-free survival (PFS) o Overall survival (OS) o Duration of response (DOR) o Time to response (TTR), • HRQOL as assessed by the validated European Organization for Research and Treatment of Cancer (EORTC) Quality of Life Questionnaire - Cholangiocarcinoma and Gallbladder Cancer Module (QLQ-BIL21), • Health economic outcomes as assessed by the 5 level EuroQol 5-dimensional questionnaire (EQ-5D-5L), • Proportion of days at home or hospital, • Concomitant medications

Source: https://euclinicaltrials.eu/ctis-public/view/2022-501463-40-01